EU clinical trial 2024-517959-12-00: An open label, phase I/II study of Venetoclax in addition to Blinatumomab immunotherapy in adult patients with relapsed/refractory B cell precursor acute lymphoblastic leukemia (BCP-ALL)
Protocol code: GMALL-BLIVEN
Sponsor: Goethe University Frankfurt (Educational Institution). Phase: Phase I and Phase II (Integrated)- Other. Countries: Germany (ongoing, recruitment ended).
Therapeutic area(s): Diseases [C] - Hemic and Lymphatic Diseases [C15]
Gender: Female, Male. Age: 18-64 years, 65+ years. Enrolment: 21.
Status: Ongoing, recruitment ended. Start date (EU): 2024-04-11. Decision date: 2024-11-05. Results received: No. Last updated: 2025-11-06.

Condition(s): Relapsed/refractory B cell precursor acute lymphoblastic leukemia
Product: Venclyxto 10 mg film-coated tablets, Venclyxto 100 mg film-coated tablets, Venclyxto 50 mg film-coated tablets, BLINCYTO 38.5 micrograms powder for concentrate and solution for solution for infusion.

Primary endpoint: Phase I: Maximum tolerated dose (MTD) Phase II: mol-CR rate in patients with CR/CRh/CRi as assessed by molecular MRD analyses of bone marrow cells obtained after one treatment cycle

Source: https://euclinicaltrials.eu/ctis-public/view/2024-517959-12-00